EU clinical trial 2024-519777-19-00: Changes in airway cross sectional areas during residual neuromuscular blockade, and after reversal
Protocol code: AITT 2022/5
Sponsor: University Of Debrecen (Educational Institution). Phase: Therapeutic use (Phase IV). Countries: Hungary (authorised, recruitment pending).
Therapeutic area(s): Analytical, Diagnostic and Therapeutic Techniques and Equipment [E] - Anesthesia and Analgesia [E03]
Gender: Female, Male. Age: 18-64 years, 65+ years. Enrolment: 75.
Status: Authorised, recruitment pending. Decision date: 2025-01-03. Results received: No. Last updated: 2025-01-03.

Condition(s): Detection of residual neuromuscular blockade after extubation by measuring upper airway diameter
Product: Sugammadex Amomed 100 mg/ml solution for injection, Esmeron 10 mg/ml oldatos injekció

Primary endpoint: The differences in retroglossal pharyngeal cross sectional areas (inspiration and exspiration) measured at different TOF values

Source: https://euclinicaltrials.eu/ctis-public/view/2024-519777-19-00